EU clinical trial 2024-515450-24-00: The Effect of tinzaparin on Biomarkers in FIGO Stage III-IV Ovarian Cancer Patients Undergoing Neoadjuvant Chemotherapy – A randomized pilot study
Protocol code: TABANETOC
Sponsor: Region Oestergoetland (Hospital/Clinic/Other health care facility). Phase: Therapeutic exploratory (Phase II). Countries: Sweden (ongoing, recruiting).
Therapeutic area(s): Diseases [C] - Neoplasms [C04]
Gender: Female. Age: 18-64 years, 65+ years. Enrolment: 40.
Status: Ongoing, recruiting. Start date (EU): 2022-04-22. Decision date: 2024-10-25. Results received: No. Last updated: 2026-02-16.

Condition(s): Epithelial ovarian cancer
Product: TINZAPARIN

Primary endpoint: Level of CA-125 measured before cycles one-four of chemotherapy and preoperatively before DPDS.
Endpoint(s): Levels of hemoglobin, platelets, leucocytes, CRP, albumin, IL-6 and VEGF before every cycle of chemotherapy, preoperatively before DPDS and three weeks after the last cycle of chemotherapy., CA-125 measured before cycles five-seven of chemotherapy and three weeks after the last cycle of chemotherapy, The compliance to tinzaparin injections and occurrence of adverse events related to tinzaparin will be evaluated., Objectively confirmed VTE, i.e. pulmonary embolism, lower-limb deep vein thrombosis or upper extremity deep vein thrombosis. Death due to VTE.

Source: https://euclinicaltrials.eu/ctis-public/view/2024-515450-24-00